EU clinical trial 2025-521877-14-00: Guttmann NeuroRecovery – Feasibility, safety and efficacy of intrathecal Wharton's jelly-derived mesenchymal stem cells and transcutaneous spinal cord stimulation in the rehabilitation of chronic spinal cord injuries: a pilot study
Protocol code: 2025-521877-14-00
Sponsor: Fundacio Institut Guttmann (Hospital/Clinic/Other health care facility). Phase: Phase I and Phase II (Integrated)- Other. Countries: Spain (ongoing, recruiting).
Therapeutic area(s): Diseases [C] - Nervous System Diseases [C10]
Gender: Female, Male. Age: 18-64 years, 65+ years. Enrolment: 10.
Status: Ongoing, recruiting. Start date (EU): 2026-03-11. Decision date: 2026-01-28. Results received: No. Last updated: 2026-01-28.

Condition(s): Traumatic spinal cord injury

Primary endpoint: The safety assessment will take into account adverse events (AEs), physical examination, vital signs, and laboratory data. AEs of special interest will be specifically identified. AEs will be coded using MedDRA™. All AEs will be summarized with the number and percentage of patients with an AE, as well as the number and incidence of AEs by MedDRA™. Serious AEs (SSAs) will be highlighted and listed. Safety will be assessed using descriptive statistics in the safety population.
Endpoint(s): Continuous variables assessed repeatedly over time will be analysed using mixed models for repeated measurements (longitudinal Mixed Model for Repeated Measurements (MMRM)), which will include time as a random factor, treatment as a fixed factor, and the interaction between time and treatment. The presence or absence of anti-HLA antibodies in CSF after the first and third infusions of WJ-MSC ( weeks 1 and 9) will be estimated using a logistic regression model.

Source: https://euclinicaltrials.eu/ctis-public/view/2025-521877-14-00